EU clinical trial 2024-520291-10-01: Prospective Randomised Nordic Frostbite Treatment Study comparing tPA and iloprost therapy
Sponsor: HUS-Yhtymae (Hospital/Clinic/Other health care facility). Phase: Therapeutic use (Phase IV). Countries: Finland (authorised, recruitment pending).
Therapeutic area(s): Diseases [C] - Skin and Connective Tissue Diseases [C17]
Gender: Female, Male. Age: 18-64 years, 65+ years. Enrolment: 100.
Status: Authorised, recruitment pending. Decision date: 2025-01-30. Results received: No. Last updated: 2025-01-30.

Condition(s): Frostbite injury to extremities
Product: ALTEPLASE, ILOPROST

Primary endpoint: level of distal extremity / digital amputation

Source: https://euclinicaltrials.eu/ctis-public/view/2024-520291-10-01